EU clinical trial 2024-516971-34-00: First-in-man clinical trial to assess safety and tolerability of CEB-01 PLGA membrane in patients with recurrent or locally advanced retroperitoneal soft tissue sarcoma after surgery
Protocol code: CEB-01-RLS01-CT
Sponsor: Cebiotex S.L. (Pharmaceutical company). Phase: Human Pharmacology (Phase I)- First administration to humans. Countries: Spain (ended).
Therapeutic area(s): Diseases [C] - Neoplasms [C04]
Gender: Female, Male. Age: 18-64 years, 65+ years. Enrolment: 21.
Status: Ended. Start date (EU): 2024-08-20. End date (EU): 2025-11-28. Decision date: 2024-08-20. Results received: No. Last updated: 2024-08-20.

Condition(s): Recurrent or locally advanced retroperitoneal soft tissue sarcoma

Source: https://euclinicaltrials.eu/ctis-public/view/2024-516971-34-00